EU clinical trial 2024-517594-24-01: CAT-01
Sponsor: Karolinska Institutet (Educational Institution). Phase: Phase I and Phase II (Integrated)- Other. Countries: Sweden (authorised, recruitment pending).
Therapeutic area(s): Diseases [C] - Neoplasms [C04]
Gender: Female. Age: 18-64 years, 65+ years. Enrolment: 20.
Status: Authorised, recruitment pending. Decision date: 2026-03-09. Results received: No. Last updated: 2026-03-09.

Condition(s): Cervical carcinoma

Source: https://euclinicaltrials.eu/ctis-public/view/2024-517594-24-01